EU clinical trial 2022-500363-12-00: Efficacy and Safety of AXL-Inhibitor bemcentinib for the Treatment of Moderate COVID-19 (AXL-SolidAct)
Protocol code: AXL-SolidAct
Sponsor: Oslo University Hospital Hf (Hospital/Clinic/Other health care facility). Phase: Therapeutic exploratory (Phase II). Countries: Greece (ended), Luxembourg (ended), Czechia (ended), Ireland (ended), France (ended), Slovakia (ended), Belgium (ended), Norway (ended), Spain (ended), Italy (ended).
Therapeutic area(s): Diseases [C] - Virus Diseases [C02]
Gender: Female, Male. Age: 18-64 years, 65+ years. Enrolment: 400.
Status: Ended. Start date (EU): 2022-08-24. End date (EU): 2023-12-08. Decision date: 2022-07-05. Results received: Yes. Last updated: 2023-07-04.
Decision dates by country: CZ: 2022-07-12, LU: 2022-07-08, ES: 2022-09-09, IE: 2022-07-26, IT: 2022-11-04, NO: 2022-08-01, SK: 2022-07-11, FR: 2022-07-06, GR: 2022-07-07, BE: 2022-09-08

Condition(s): SARS CoV-2 (COVID-19)
Product: BEMCENTINIB, Bemcentinib Placebo Capsules: blend of excipients inside size 0 Swedish Orange Hypromellose capsules

Primary endpoint: Disease state on the 11-point WHO progression scale at Day 8.
Endpoint(s): Occurrence of disease progression, defined as a progression of disease state from moderate (WHO score 4-5) to severe/critical (WHO score 6-9) or death (WHO score 10) within 14 days., Occurrence of disease progression by at least 1 point increase on the 11-point WHO clinical progression scale from baseline within 14 days and 28 days of enrolment., Disease state on the 11-point WHO scale at Day 15 and Day 29., SaO2/FiO2 ratio at day 8., Occurrence of death within 28 and 60 days., Time from randomization to sustained recovery, defined as being discharged from the index hospitalization, followed by being alive and home for 14 consecutive days within 90 days., Time from randomization to first hospital discharge within 90 days., Occurrence of serious adverse events leading to study treatment discontinuation or death., Viral clearance as assessed by SARS-CoV2 PCR in naso/oropharyngeal specimens and saliva during hospitalization., Inflammatory biomarkers (CRP, ferritin, LDH, leukocyte subsets, D-dimer, suPAR, cytokine panels) during hospitalisation., Patient related outcome measures (PROM) by the Oslo COVID-19 QLQ-PW80 questionnaire after 90 days., Occurrence of any treatment emerging adverse events, including adverse events of special interest.

Source: https://euclinicaltrials.eu/ctis-public/view/2022-500363-12-00